EU clinical trial 2023-508267-69-00: A dose-escalation and expansion study of the safety and pharmacokinetics of XB002 as single-agent and combination therapy in subjects with inoperable locally advanced or metastatic solid tumors
Protocol code: XB002-101
Sponsor: Exelixis Inc. (Pharmaceutical company). Phase: Human Pharmacology (Phase I)- Other. Countries: Netherlands (ended), Spain (ended), Belgium (ended), France (ended), Italy (ended).
Therapeutic area(s): Diseases [C] - Neoplasms [C04]
Gender: Female, Male. Age: 18-64 years, 65+ years. Enrolment: 222.
Status: Ended. Start date (EU): 2023-08-11. End date (EU): 2025-03-10. End date: 2025-03-11. Decision date: 2024-09-09. Results received: No. Last updated: 2024-10-07.
Decision dates by country: BE: 2024-09-16, FR: 2024-09-30, IT: 2024-10-07, ES: 2024-09-09, NL: 2024-09-10

Condition(s): Subjects with Aadvanced solid tumors for whom life-prolonging therapies do not exist or available therapies are intolerable or no longer effective. Single-agent XB002 will be evaluated up to 10 tumor types, and combination treatment will also be evaluated with nivolumab in NSCLC, SCCHN, and esophageal SCC, and for XB002 plus bevacizumab in EOC.

Source: https://euclinicaltrials.eu/ctis-public/view/2023-508267-69-00